EU clinical trial 2024-513778-23-00: A randomized double-blind placebo-controlled study with ASA treatment in colorectal cancer patients with mutations in the PI3K signaling pathway
Sponsor: Karolinska Institutet (Educational Institution). Phase: Therapeutic confirmatory (Phase III). Countries: Finland (authorised, recruitment pending), Sweden (authorised, recruitment pending), Denmark (authorised, recruitment pending), Norway (authorised, recruitment pending).
Therapeutic area(s): Diseases [C] - Neoplasms [C04]
Gender: Female, Male. Age: 18-64 years, 65+ years. Enrolment: 700.
Status: Authorised, recruitment pending. Decision date: 2024-10-01. Results received: No. Last updated: 2024-10-29.
Decision dates by country: DK: 2024-10-03, FI: 2024-10-01, NO: 2024-10-15, SE: 2024-10-01

Condition(s): Colon and rectal cancer tumor stage II-III, tumor with somatic alterationsin PIK3CA, PIK3R1 or PTEN
Product: The placebo tablet composition is: Collodial silicone dioxide, Magnesium stearate, Carmellose sodium, Cellulosa powder. Appearance and size will be the same for active and placebo., Trombyl 160 mg tabletter

Primary endpoint: • TTR at 3 years, in patients with tumors harboring PIK3CA mutations in exon 9 and 20

Source: https://euclinicaltrials.eu/ctis-public/view/2024-513778-23-00